EU clinical trial 2023-505935-11-00: Comparing Chlorhexidine and Ethanol ahead of cannulation for haemodialysis - A randomized crossover trial
Sponsor: Region Oestergoetland (Hospital/Clinic/Other health care facility). Phase: Therapeutic use (Phase IV). Countries: Sweden (ended).
Therapeutic area(s): Not possible to specify
Gender: Female, Male. Age: 18-64 years, 65+ years. Enrolment: 20.
Status: Ended. Start date (EU): 2023-12-12. End date (EU): 2024-08-30. Decision date: 2023-08-16. Results received: No. Last updated: 2023-08-16.

Condition(s): Hemodialys

Source: https://euclinicaltrials.eu/ctis-public/view/2023-505935-11-00